EU clinical trial 2024-514254-69-00: I3X-MC-JHTB: A Phase 2 Study of LY2784544 in Patients with Myeloproliferative Neoplasms
Protocol code: I3X-MC-JHTB
Sponsor: Eli Lilly & Co. (Pharmaceutical company). Phase: Therapeutic exploratory (Phase II). Countries: Spain (ongoing, recruitment ended), Germany (ongoing, recruitment ended), Austria (ongoing, recruitment ended).
Therapeutic area(s): Diseases [C] - Neoplasms [C04]
Gender: Female, Male. Age: 18-64 years, 65+ years. Enrolment: 3.
Status: Ongoing, recruitment ended. Start date (EU): 2012-10-22. Decision date: 2024-12-09. Results received: No. Last updated: 2025-12-15.
Decision dates by country: ES: 2024-12-09, AT: 2024-12-11, DE: 2024-12-11

Condition(s): Myeloproliferative neoplasms (MPNs), myelofibrosis, essential thrombocythemia, and polycythemia vera

Primary endpoint: The primary objective of this study is to assess the activity of LY2784544 therapy administered once daily, as measured by objective response rate, in patients with the myeloproliferative neoplasms (MPNs), polycythemia vera (PV), essential thrombocytopenia (ET) or myelofibrosos (MF) including those who have demonstrated an intolerance to, failure of primary response to, or have demonstarted disease progression while on ruxolitinib.
Endpoint(s): To characterise the toxicity profile To assess response criteria To assess efficacy To characterise PD-PHK

Source: https://euclinicaltrials.eu/ctis-public/view/2024-514254-69-00